EU clinical trial 2023-509737-39-00: Double-blind, Randomized, Placebo-controlled, Prospective Phase III Study Evaluating Efficacy and Safety of Panzyga in Primary Infection Prophylaxis in Patients with Chronic Lymphocytic Leukemia (“PRO-SID” study).
Protocol code: NGAM-12
Sponsor: Octapharma Pharmazeutika Produktionsgesellschaft mbH (Pharmaceutical company). Phase: Therapeutic confirmatory (Phase III). Countries: Hungary (ended), Greece (ended), Czechia (ended), Italy (ended), Spain (ended), Poland (ended), Denmark (ended).
Therapeutic area(s): Diseases [C] - Neoplasms [C04]
Gender: Female, Male. Age: 18-64 years, 65+ years. Enrolment: 182.
Status: Ended. Start date (EU): 2020-08-19. End date (EU): 2025-04-16. End date: 2025-09-20. Decision date: 2024-02-26. Results received: No. Last updated: 2026-06-11.
Decision dates by country: CZ: 2024-03-01, DK: 2024-02-26, GR: 2024-04-29, HU: 2024-02-26, ES: 2024-02-26, IT: 2024-02-26, PL: 2024-02-29

Condition(s): Primary infection prophylaxis in patients with chronic lymphocytic leukemia (CLL) and secondary hypogammaglobulinemia.
Product: Panzyga 100 mg/ml Infusionslösung, Isotone Kochsalz-Lösung 0,9 % Braun Infusionslösung

Primary endpoint: Since the study objective is to show the benefit of Panzyga administration as primary infection prophylaxis, the primary endpoint is not the major infection rate but occurrence of at least one major infection in CLL patients with or without primary infection prophylaxis with Panzyga. Please refer to the Protocol for more information on the Primary endpoint.
Endpoint(s): 1. Overall infection rate: infection rate for all infections., 2. Frequency of prophylaxis with anti-infectives (antibacterials and antivirals)., 3. Duration of prophylaxis with anti-infectives (antibacterials and antivirals).

Source: https://euclinicaltrials.eu/ctis-public/view/2023-509737-39-00